EU clinical trial 2025-521510-25-00: A phase 2 randomized, double blind, placebo-controlled study to evaluate the safety and efficacy of topical AT-004 1% in the participants with acne vulgaris.
Protocol code: AT-004_2024
Sponsor: Arctic Therapeutics hf. (Pharmaceutical company). Phase: Therapeutic exploratory (Phase II). Countries: Denmark (ended).
Therapeutic area(s): Diseases [C] - Skin and Connective Tissue Diseases [C17]
Gender: Female, Male. Age: 18-64 years. Enrolment: 60.
Status: Ended. Start date (EU): 2026-01-13. End date (EU): 2026-07-29. Decision date: 2025-11-07. Results received: No. Last updated: 2025-12-19.

Condition(s): Acne vulgaris
Product: Matched Placebo for IMP

Primary endpoint: Nature, incidence and severity of adverse events (AEs), along with changes in laboratory safety parameters, vital signs, physical examination, and body weight., Nature, incidence, and severity of skin reactions at the application site, Proportion of successes according to IGA score at week 8., Absolute change in number of inflammatory lesions at week 8., Absolute change in number of noninflammatory lesions at week 8.
Endpoint(s): Proportion of successes according to IGA score at weeks 4 and 12., Absolute change in number of inflammatory lesions at wees 4 and 12., Absolute change in number of noninflammatory lesions at weeks 4 and 12., Percent change in number of inflammatory lesions at weeks 4, 8 and 12., Percent change in number of noninflammatory lesions at weeks 4, 8 and 12, Establish pharmacokinetics of AT-004 in a subset of 5 participants., Change in Dermatology Life Quality Index (DLQI) score from baseline to weeks 4, 8 and 12., Reduction in DLQI of >4 points from baseline to week 8 and 12 among subjects with baseline DLQI >4

Source: https://euclinicaltrials.eu/ctis-public/view/2025-521510-25-00